EU clinical trial 2025-524022-18-00: A multicenter prospective trial estimating the persistence of remission after stopping BCMA-CD3 bispecific antibody in multiple myeloma patients with major M-spike response by use MaldiTOF-based high sensitivity monitoring
Protocol code: SWE-DISCO-MM1
Sponsor: Vaestra Goetalandsregionen (Hospital/Clinic/Other health care facility). Phase: Therapeutic exploratory (Phase II). Countries: Sweden (ongoing, recruiting).
Therapeutic area(s): Diseases [C] - Neoplasms [C04]
Gender: Female, Male. Age: 18-64 years, 65+ years. Enrolment: 200.
Status: Ongoing, recruiting. Start date (EU): 2026-05-22. Decision date: 2026-02-16. Results received: No. Last updated: 2026-02-16.

Condition(s): Multiple myeloma
Product: ELREXFIO 40 mg/mL solution for injection, TECVAYLI 90 mg/mL solution for injection

Primary endpoint: The primary endpoint is disease free survival (DFS) based on sustained MMR after 6 months and 3 years.
Endpoint(s): Efficacy: Survival: Overall Survival (OS) and Progression-Free Survival (PFS)., Efficacy: Relapse: a. Incidence of MMR loss at 6 months and 3 years. b. Incidence of clinical relapse (as per IMWG criteria) at 6 months and 3 years. c. Median time to MMR loss and to clinical relapse., Efficacy: Treatment Re-response: Proportion of patients achieving at new MMR upon re-initiation of therapy., Safety: Incidence and severity of adverse events, with special focus on infection rates (events per patient-year) during treatment versus after treatment discontinuation., Healthcare Utilization & Economics: Number of hospitalization days per patient-year before versus after treatment discontinuation., Healthcare Utilization & Economics: A health economic analysis assessing cost-effectiveness and resource utilization associated with treatment discontinuation., Patient-Reported Outcomes: Change from baseline in patient-reported Quality of Life (QoL) and symptom burden, measured using EQ-5D, assessed at serial time points throughout the study., Exploratory & Biomarker Analyses: Analysis of baseline factors (e.g., age, disease stage, cytogenetic risk, time since diagnosis, depth of initial response, refractoriness to prior lines of therapy) associated with: a. The risk of disease relapse (molecular and clinical). b. The durability of treatment-free remission.

Source: https://euclinicaltrials.eu/ctis-public/view/2025-524022-18-00